EU clinical trial 2025-520852-27-00: RANDOMIZED, CROSSOVER, TWO-PERIOD, COMPARATIVE BIOAVAILABILITY STUDY OF TWO IBUPROFEN FORMULATIONS, AFTER A SINGLE ORAL DOSE OF 400 MG IN SOLUTION FORM TO HEALTHY SUBJECTS UNDER FASTING CONDITIONS
Protocol code: FMLD- IOSOLwW-64
Sponsor: Farmalider S.A. (Pharmaceutical company). Phase: Human Pharmacology (Phase I)- Other. Countries: Spain (ended).
Therapeutic area(s): Not possible to specify
Gender: Female, Male. Age: 18-64 years. Enrolment: 24.
Status: Ended. Start date (EU): 2025-09-18. End date (EU): 2025-11-07. Decision date: 2025-03-11. Results received: No. Last updated: 2025-08-21.

Condition(s): Healthy volunteers

Source: https://euclinicaltrials.eu/ctis-public/view/2025-520852-27-00